EU clinical trial 2023-505225-13-00: Single-arm, open label, multicenter clinical study to evaluate the handling and safety of AVT06 pre-filled syringe (PFS) in subjects with chorioretinal vascular disease followed by an optional extension phase of AVT06 pre-filled syringe (PFS).
Protocol code: AVT06-GL-D01
Sponsor: Alvotech Swiss AG (Pharmaceutical company). Phase: Therapeutic confirmatory (Phase III). Countries: Latvia (ended).
Therapeutic area(s): Diseases [C] - Eye Diseases [C11]
Gender: Female, Male. Age: 18-64 years, 65+ years. Enrolment: 23.
Status: Ended. Start date (EU): 2024-03-11. End date (EU): 2025-03-18. End date: 2025-05-22. Decision date: 2023-11-06. Results received: Yes. Last updated: 2025-03-07.

Condition(s): chorioretinal vascular disease (neovascular age-related macular degeneration [nAMD], diabetic macular edema [DME], myopic choroidal neovascularization [CNV], retinal vein occlusion [RVO] and diabetic retinopathy [DR])
Product: Aflibercept

Primary endpoint: 1. Proportion of AVT06 injections successfully administered with PFS at Day 1. 2. Incidence of ocular TEAEs, AESIs, and SAEs associated with the study eye from Baseline to Week 4.

Source: https://euclinicaltrials.eu/ctis-public/view/2023-505225-13-00